EU clinical trial 2024-514289-38-00: A phase III, double blind, randomised, two arms, parallel study to compare the efficacy and safety of a 12-week administration of two fixed-dose combinations (Rosuvastatin 20 mg and Fenofibrate 160 mg versus Pravastatin 40 mg and Fenofibrate 160 mg (Pravafenix®)) in patients with mixed dyslipidaemia.
Protocol code: ROFE-III-24-1
Sponsor: Laboratoires S.M.B. (Pharmaceutical company). Phase: Therapeutic confirmatory (Phase III). Countries: Greece (ongoing, recruiting).
Therapeutic area(s): Diseases [C] - Nutritional and Metabolic Diseases [C18]
Gender: Female, Male. Age: 18-64 years, 65+ years. Enrolment: 150.
Status: Ongoing, recruiting. Start date (EU): 2025-06-26. Decision date: 2025-02-17. Results received: No. Last updated: 2026-05-19.
Decision dates by country: GR: 2025-04-10

Condition(s): Dyslipidaemia
Product: Pravafenix 40 mg/160 mg hard capsules

Primary endpoint: Mean percent change from baseline (V2) to week 12 (V4) in Low-Density Lipoprotein (LDL) cholesterol.
Endpoint(s): Mean percent change from baseline (V2) to week 12 (V4) in non-High-Density Lipoprotein (non-HDL) cholesterol., Mean percent change from baseline (V2) to week 12 (V4) in HDL cholesterol., Mean percent change from baseline (V2) to week 12 (V4) in Triglycerides., Mean percent change from baseline (V2) to week 12 (V4) in Total cholesterol., Mean percent change from baseline (V2) to week 12 (V4) in Apolipoprotein B (ApoB)., Percentage of participants who achieve LDL-C < 55 mg/dL (for very-high risk) or < 70 mg/dL (for high risk)., Incidence in adverse events including adverse events (AEs), serious adverse events (SAEs), and suspected unexpected serious adverse reactions (SUSARs)., Adverse events of special interest: myopathy, rhabdomyolysis., Absolute Change from baseline in laboratory data., Withdrawal rate

Source: https://euclinicaltrials.eu/ctis-public/view/2024-514289-38-00